EU clinical trial 2025-520842-31-00: ANTIPROM - Comparison of two prophylactic antibiotic regimens in case of preterm prelabor rupture of membranes before 34 weeks of gestation: a randomized controlled trial
Protocol code: APHP230841
Sponsor: Assistance Publique Hopitaux De Paris (Hospital/Clinic/Other health care facility). Phase: Therapeutic confirmatory (Phase III). Countries: France (authorised, recruitment pending).
Therapeutic area(s): Diseases [C] - Female Urogenital Diseases and Pregnancy Complications [C13]
Gender: Female. Age: 18-64 years. Enrolment: 1008.
Status: Authorised, recruitment pending. Decision date: 2026-04-28. Results received: No. Last updated: 2026-04-28.

Condition(s): Population of study participants Pregnant women with PPROM at 22 to 33 weeks’ gestation
Product: CEFTRIAXONE, AMOXICILLIN, AZITHROMYCIN

Primary endpoint: Composite outcome including foetal death and/or neonatal death AND/OR neonatal severe morbidity (defined by ≥ 1 of the following: mechanical ventilation 48hrs, severe bronchopulmonary dysplasia, severe intraventricular haemorrhage, white matter injury, neonatal early-onset sepsis, neonatal late-onset sepsis, necrotizing enterocolitis, retinopathy of prematurity).
Endpoint(s): Pregnancy duration, Maternal infectious morbidity, Neonatal mild or moderate morbidity: 1. Prevalence of maternal or neonatal colonization/infection with ESBL- or 3rd generation cephalosporin-resistant- enterobacteria ; 2. Psycho-motor development at the age of 2 years by parental auto-questionnaire

Source: https://euclinicaltrials.eu/ctis-public/view/2025-520842-31-00